EU clinical trial 2022-500035-36-01: VASODILATATION OR LOOP-DIURETICS FOR INITIAL TREATMENT OF PULMONARY CONGESTION DUE TO ACUTE HEART FAILURE – A RANDOMIZED PLACEBO-CONTROLLED TRIAL
Sponsor: Bispebjerg Hospital (Hospital/Clinic/Other health care facility). Phase: Therapeutic use (Phase IV). Countries: Denmark (ongoing, recruiting).
Therapeutic area(s): Diseases [C] - Cardiovascular Diseases [C14]
Gender: Female, Male. Age: 18-64 years, 65+ years. Enrolment: 1041.
Status: Ongoing, recruiting. Start date (EU): 2023-09-14. Decision date: 2022-06-28. Results received: No. Last updated: 2026-01-28.

Condition(s): Acute heart failure with pulmonary congestion
Product: Isoket, Isotonisk saltvand fremstillet af sygehusapoteket, Isotonisk saltvand fremstillet af sygehusapoteket, Furosemide 10 mg/ml Solution for Injection or Infusion

Primary endpoint: Days alive and outside hospital until day 30
Endpoint(s): Intensification of therapy defineds as at least one of: mechanical ventilation, renal replacement therapy, vasopressors, inotropes, or mechanical heart failure treatment., Clinical benefit at 30 days, consisting of a composite of 1. All-cause death, 2. Intubation with mechanical ventilation, and 3. rehospitalization, , assessed using a ’win-ratio’ approach., NT-proBNP at day 1-3, Early Warning Score measured 6-24 hours after start of intervention, Adverse events, Patient-reported dyspnea assessment after 212--24 hours (7-point Likert scales in a standardized position: marked improvement from admission = 3, moderate improvement = 2, slight improvement = 1, no change = 0, slight worsening = -1, moderate worsening = -2, marked worsening = - 3

Source: https://euclinicaltrials.eu/ctis-public/view/2022-500035-36-01